EU clinical trial 2024-512877-28-00: A Phase I Study Using Hepatic Arterial Infusion of Autologous Tumor Infiltrating Lymphocytes in Patients with Melanoma and Liver Metastases
Sponsor: Vaestra Goetalandsregionen (Hospital/Clinic/Other health care facility). Phase: Human Pharmacology (Phase I)- Other. Countries: Sweden (ended).
Therapeutic area(s): Diseases [C] - Neoplasms [C04]
Gender: Female, Male. Age: 18-64 years, 65+ years. Enrolment: 6.
Status: Ended. Start date (EU): 2024-10-23. End date (EU): 2025-10-27. Decision date: 2024-10-23. Results received: No. Last updated: 2024-10-23.

Condition(s): Metastases to liver, Skin melanomas, Uveal melanoma with liver metastases, Ocular melanomas

Source: https://euclinicaltrials.eu/ctis-public/view/2024-512877-28-00